EU clinical trial 2023-504631-40-01: Treating severe brain-injured patients with apomorphine : a behavioural and neuroimaging study
Sponsor: Universite De Liege, CHU De Liege (Educational Institution, Hospital/Clinic/Other health care facility). Phase: Therapeutic exploratory (Phase II). Countries: Belgium (ongoing, recruiting), Spain (authorised, recruitment pending).
Therapeutic area(s): Diseases [C] - Nervous System Diseases [C10]
Gender: Female, Male. Age: 18-64 years, 65+ years. Enrolment: 102.
Start date (EU): 2018-09-05. Decision date: 2024-09-16. Results received: No. Last updated: 2025-07-24.
Decision dates by country: BE: 2024-09-16, ES: 2025-07-24

Condition(s): Disorder of Consciousness, severe brain injury
Product: Sodium Chloride 0,9%, Apomorphine hydrochloride 5 mg/ml, solution for infusion

Primary endpoint: Change of diagnosis from baseline in Coma Recovery Scale - Revised (CRS-R)
Endpoint(s): Change of total score in Nociception Coma Scale - Revised (NCS-R), Changes in EEG spectral power within fixed bands or dynamic connectivity using median spectral connectivity and graph-theoretic topology metrics, Changes in the probabilty of consciousness using a multivariate EEG classifier based on a machine-learning approach using 120 EEG markers, Changes in quantification of PET signal using standardized uptake values of fluorodeoxyglucose, Changes in MRI functional connectivity using a seed-voxel approach, between regions of interest (here: striatum, globus pallidus interna, thalamus and prefrontal cortex) and the time course from all other brain voxels, Change in circadian rhythmicity using actimetry and body temperature variations, Change in the architecture of sleep cycles using night EEG, Change of score in Glasgow Outcome Scale - Extended (GOS-E), Change in diagnosis in Phone-adapted CRS-R

Source: https://euclinicaltrials.eu/ctis-public/view/2023-504631-40-01